EU clinical trial 2023-507064-39-00: A randomized, double-blind, placebo-controlled phase III study to evaluate the efficacy, safety, and tolerability of iptacopan in patients with generalized Myasthenia Gravis, followed by an open label extension phase
Protocol code: CLNP023Q12301
Sponsor: Novartis Pharma AG (Pharmaceutical company). Phase: Therapeutic confirmatory (Phase III). Countries: Portugal (ongoing, recruiting), Italy (ongoing, recruiting), Spain (ongoing, recruiting), Poland (ongoing, recruiting), Greece (ongoing, recruiting), Denmark (ongoing, recruiting), Netherlands (authorised, recruitment pending), Germany (ongoing, recruiting), France (authorised, recruitment pending).
Therapeutic area(s): Diseases [C] - Nervous System Diseases [C10]
Gender: Female, Male. Age: 18-64 years, 65+ years. Enrolment: 65.
Start date (EU): 2024-09-26. Decision date: 2024-06-26. Results received: No. Last updated: 2026-02-23.
Decision dates by country: PT: 2024-06-26, FR: 2025-09-19, NL: 2025-07-10, PL: 2024-07-01, ES: 2024-06-26, GR: 2024-06-28, DE: 2025-09-18, IT: 2024-06-26, DK: 2025-06-27

Condition(s): generalized Myasthenia Gravis
Product: Placebo 0 mg hard gelatin capsule size 0, (placebo to LNP023), IPTACOPAN

Primary endpoint: Change from baseline to Month 6 in Myasthenia Gravis Activity of Daily Living (MG-ADL) total score
Endpoint(s): Change from baseline to Month 6 in Quantitative MG (QMG) total score, Proportion of participants with ≥5 points reduction from baseline to Month 6 of QMG total score without rescue medication and/or strongly confounding prohibited medication, Proportion of participants with ≥3 points reduction from baseline to Month 6 of MG-ADL total score without rescue medication and/or strongly confounding prohibited medication, Change from baseline to Month 6 in Myasthenia Gravis Composite (MGC) total score, Change from baseline to Month 6 in revised MG Quality of Life Questionnaire (MG-QOL15r) survey score, Incidence of adverse events and changes in clinical laboratory values, vital signs, and electrocardiograms, Columbia Suicide Severity Rating, Proportion of time during which participants showed a reduction of ≥ 2 points in MG-ADL total score that was maintained up to Month 6, Proportion of early MG-ADL responders during treatment (early responders with first MG-ADL improvement from baseline of ≥2 points occurring by week 4）, Change from baseline to Month 6 in EuroQol-5 Dimensions-5 Level (EQ-5D-5L), Change from baseline in MG-ADL total score, Proportion of participants achieving a reduction in oral corticosteroids (OCS) dose compared to Core Part that was maintained up to end of Extension Part, Incidence of adverse events and changes in clinical laboratory values, vital signs, and electrocardiograms, Columbia Suicide Severity Rating, Proportion of participants achieving MSE at Month 6, defined as MG-ADL score of 0 or 1 at Month 6 without rescue therapy and/or strongly confounding prohibited medication, Proportion of participants with reduction of ≥ 3 points from baseline to Month 6 in MGC total score

Source: https://euclinicaltrials.eu/ctis-public/view/2023-507064-39-00